EU clinical trial 2023-506660-13-00: A Phase 4 Study to Evaluate the Safety, Pharmacokinetics and Efficacy of Oral B/F/TAF after Discontinuing Injectable CAB + RPV
Protocol code: GS-US-380-6738
Sponsor: Gilead Sciences Inc. (Pharmaceutical company). Phase: Therapeutic use (Phase IV). Countries: France (ended).
Therapeutic area(s): Diseases [C] - Virus Diseases [C02]
Gender: Female, Male. Age: 18-64 years, 65+ years. Enrolment: 10.
Status: Ended. Start date (EU): 2024-03-07. End date (EU): 2025-02-04. End date: 2025-04-23. Decision date: 2024-02-07. Results received: Yes. Last updated: 2025-02-04.
Decision dates by country: FR: 2024-05-13

Condition(s): HIV-1 infection
Product: Biktarvy 50 mg/200 mg/25 mg film-coated tablets

Primary endpoint: Proportion of participants experiencing treatment-emergent Grade 3 or 4 study drug-related adverse events (AEs) through Week 12, Proportion of participants experiencing treatment-emergent Grade 3 or 4 laboratory abnormalities through Week 12
Endpoint(s): Plasma concentrations of BIC, CAB and RPV at Day 1, Week 4, 12, and 24, as appropriate, Proportion of participants with HIV-1 RNA ≥ 50 copies/mL at Weeks 12 and 24 (missing = excluded and discontinuation = failure), Number and proportion of participants with B/F/TAF discontinuation by Weeks 12 and 24, Proportion of participants experiencing treatment-emergent grade 3 or 4 laboratory abnormalities through Week 24, Change in HIV treatment satisfaction (HIVTSQc) score at Week 4

Source: https://euclinicaltrials.eu/ctis-public/view/2023-506660-13-00